EU clinical trial 2024-515152-20-00: Exploiting circulating tumour DNA to intensify the postoperative treatment of stage III and high-risk stage II resected colon cancer patients with adjuvant FOLFOXIRI and/or post-adjuvant Trifluridine/Tipiracil. ERASE-CRC
Protocol code: ERASE-CRC
Sponsor: Gruppo Oncologico Del Nord Ovest (Patient organisation/association). Phase: Therapeutic exploratory (Phase II). Countries: Italy (temporarily halted).
Therapeutic area(s): Diseases [C] - Neoplasms [C04]
Gender: Female, Male. Age: 18-64 years, 65+ years. Enrolment: 477.
Status: Temporarily halted. Start date (EU): 2023-03-02. Decision date: 2024-11-25. Results received: No. Last updated: 2024-11-25.

Condition(s): Stage III and high-risk stage II resected colon cancer patients.
Product: TRIFLURIDINE, IRINOTECAN, TRIFLURIDINE, CAPECITABINE, FLUOROURACIL, TUCATINIB, CAPECITABINE, TUCATINIB, CALCIUM LEVOFOLINATE, OXALIPLATIN, TRASTUZUMAB

Primary endpoint: The primary endpoint is the ct-DNA clearance rate., Part 1 of the study ct-DNA clearance rate after the end of the adjuvant treatment is defined as the percentage of patients, relative to the total of enrolled subjects in the Part 1 of the study with undetectable ct-DNA at the end of adjuvant treatment., Target-driven part 1 of the study ct-DNA clearance rate after the end of the adjuvant treatment is defined as the percentage of patients, relative to the total of enrolled subjects in the target-driven part 1 of the study with undetectable ct-DNA at the end of adjuvant treatment., Part 2 of the study ct-DNA clearance rate after the end of post-adjuvant treatment is defined as the percentage of patients, relative to the total of enrolled subjects in the Part 2 of the study with undetectable ct-DNA at the end of post-adjuvant treatment.
Endpoint(s): Part 1 of the study Overall Toxicity Rate 1 is defined as the percentage of patients, relative to the total of enrolled subjects in the Part 1 of the study, experiencing any adverse event, according to National Cancer Institute Common Toxicity Criteria (version 5.0), during adjuvant treatment and follow-up., Toxicity Rate 1 is defined as the percentage of patients, relative to the total of enrolled subjects in the Part 1 of the study, experiencing a specific adverse event ≥ grade 3, according to National Cancer Institute Common Toxicity Criteria (version 5.0), during adjuvant treatment and follow-up., Disease Free Survival 1 (DFS1) is defined as the time from randomization of the part 1 of the study to the first documentation of disease relapse or death due to any cause, whichever occurs first., Overall survival 1 (OS1) is defined as the time from randomization of the Part 1 of the study to the date of death due to any cause. For patients still alive at the time of the analysis, the OS time will be censored on the last date the patients were known to be alive., The analysis of PROs endpoints (assessed using the EORTC QLQ-C30, the EORTC QLQCR29 and the EuroQol EQ-5D questionnaires) will be assessed according to the EORTC Scoring and Reference Values Manual. All scores and subscales will be compared between the treatment arms., Target-driven Part 1 of the study Overall Toxicity Rate TD1 is defined as the percentage of patients, relative to the total of enrolled subjects in the target-driven part 1 of the study, experiencing any adverse event, according to National Cancer Institute Common Toxicity Criteria (version 5.0), during adjuvant treatment and follow-up., Toxicity Rate TD1 is defined as the percentage of patients, relative to the total of enrolled subjects in the target-driven part 1 of the study, experiencing a specific adverse event ≥ grade 3, according to National Cancer Institute Common Toxicity Criteria (version 5.0), during adjuvant treatment and follow-up., Disease Free Survival TD1 (DFS-TD1) is defined as the time from enrollment of the target-driven part 1 of the study to the first documentation of disease relapse or death due to any cause, whichever occurs first., Overall survival TD1 (OS-TD1) is defined as the time from enrollment of the targetdriven part 1 of the study to the date of death due to any cause. For patients still alive at the time of the analysis, the OS time will be censored on the last date the patients were known to be alive., The analysis of PROs endpoints (assessed using the EORTC QLQ-C30, the EORTC QLQCR29 and the EuroQol EQ-5D questionnaires) will be assessed according to the EORTC Scoring and Reference Values Manual. All scores and subscales will be compared between the treatment arms., Part 2 of the study Overall Toxicity Rate 2 is defined as the percentage of patients in the Part 2 of the study, relative to the total of enrolled subjects, experiencing any adverse event, according to National Cancer Institute Common Toxicity Criteria (version 5.0), during post-adjuvant treatment and follow-up., Toxicity Rate 2 is defined as the percentage of patients, relative to the total of enrolled subjects in the Part 2 of the study, experiencing a specific adverse event of ≥ grade 3, according to National Cancer Institute Common Toxicity Criteria (version 5.0), during post-adjuvant treatment and follow-up., Disease Free Survival 2 (DFS2) is defined as the time from randomization of the part 2 of the study to the first documentation of disease relapse or death due to any cause, whichever occurs first., Overall survival 2 (OS2) is defined as the time from randomization of the part 2 of the study to the date of death due to any cause. For patients still alive at the time of analysis, the OS time will be censored on the last date the patients were known to be alive., The analysis of PROs endpoints (assessed using the EORTC QLQ-C30, the EORTC QLQCR29 and the EuroQol EQ-5D questionnaires) will be assessed according to the EORTC Scoring and Reference Values Manual. All scores and subscales will be compared between the treatment arms.

Source: https://euclinicaltrials.eu/ctis-public/view/2024-515152-20-00